EU clinical trial 2022-500608-23-00: Phase 2, Open-Label Study in Subjects with Previously Untreated MET Amplified Locally Advanced/Metastatic Non-Squamous Non-Small Cell Lung Cancer (NSCLC)
Protocol code: M22-137
Sponsor: Abbvie Deutschland GmbH & Co. KG (Pharmaceutical company). Phase: Therapeutic exploratory (Phase II). Countries: Romania (ended), Germany (ended), Italy (ended), France (ended), Spain (ended).
Therapeutic area(s): Diseases [C] - Neoplasms [C04]
Gender: Female, Male. Age: 18-64 years, 65+ years. Enrolment: 20.
Status: Ended. Start date (EU): 2023-04-06. End date (EU): 2024-10-28. End date: 2024-10-29. Decision date: 2023-02-01. Results received: Yes. Last updated: 2024-08-29.
Decision dates by country: RO: 2023-02-06, ES: 2023-02-02, DE: 2023-02-01, IT: 2023-02-03, FR: 2023-02-06

Condition(s): Previously Untreated MET Amplified Locally Advanced/Metastatic Non-Squamous Non-Small Cell Lung Cancer
Product: Telisotuzumab Vedotin

Primary endpoint: Objective response rate (ORR) assessed by an independent central review (ICR).
Endpoint(s): Duration of Response (DoR), Disease control rate (DCR), Progression Free Survival (PFS) per ICR, Overall Survival (OS), Time to deterioration in cough or pain or dyspnea as measured respectively by the cough, pain, and dyspnea items of the European Organization Lung Cancer Module 13 (EORTC QLQ-LC13)., Time to deterioration of physical functioning as measured by the physical functioning domain of the EORTC-QLQ-Core 30 (EORTC QLQ-C30)., Change from baseline in quality of life as measured by the global health status/quality of life domain of the EORTC QLQ-C30.

Source: https://euclinicaltrials.eu/ctis-public/view/2022-500608-23-00